EU clinical trial 2025-524687-38-00: Phase 1/1b Study of RNDO-564 in Participants with Advanced Urothelial Cancer
Protocol code: RNDO-564-001
Sponsor: Rondo Therapeutics Inc. (Pharmaceutical company). Phase: Human Pharmacology (Phase I)- First administration to humans. Countries: Spain (authorised, recruitment pending).
Therapeutic area(s): Diseases [C] - Neoplasms [C04]
Gender: Female, Male. Age: 18-64 years, 65+ years. Enrolment: 34.
Status: Authorised, recruitment pending. Decision date: 2026-06-17. Results received: No. Last updated: 2026-06-17.

Condition(s): Other Solid Tumors Associated with Nectin-4 Expression, Relapsed/Refractory Locally Advanced or Metastatic Urothelial Cancer

Source: https://euclinicaltrials.eu/ctis-public/view/2025-524687-38-00